EU clinical trial 2025-523238-17-00: A phase II, multicentre, open label clinical trial evaluating the efficacy and safety of oral decitabine plus ivosidenib in adult patients with newly diagnosed acute myeloid leukemia older than 60 years old and/or who are ineligible for standard induction chemotherapy
Protocol code: DECISIVO
Sponsor: Fundacion PETHEMA (Patient organisation/association). Phase: Therapeutic exploratory (Phase II). Countries: Spain (authorised, recruiting).
Therapeutic area(s): Diseases [C] - Neoplasms [C04]
Gender: Female, Male. Age: 18-64 years, 65+ years. Enrolment: 50.
Status: Authorised, recruiting. Start date (EU): 2026-06-12. Decision date: 2026-02-19. Results received: No. Last updated: 2026-07-17.

Condition(s): Acute myeloid leukemia
Product: Inaqovi 35 mg/100 mg film-coated tablets, Tibsovo 250 mg film-coated tablets

Primary endpoint: Complete response (CR)/Immunophenotipic complete response (CRi), Safety
Endpoint(s): Overall survival (OS), Event-free survival (EFS)

Source: https://euclinicaltrials.eu/ctis-public/view/2025-523238-17-00